EU clinical trial 2024-516475-32-00: Open-label, non-randomised, single-dose, one sequence, two-period, cross-over study to investigate the effect of inhibition of P-glycoprotein and breast cancer resistance protein transporters by cyclosporine on the pharmacokinetics of CHF6001 in healthy volunteers.
Protocol code: CLI-06001AA1-06
Sponsor: Chiesi Farmaceutici S.p.A. (Pharmaceutical company). Phase: Human Pharmacology (Phase I)- Other. Countries: Bulgaria (ended).
Therapeutic area(s): Diseases [C] - Respiratory Tract Diseases [C08]
Gender: Female, Male. Age: 18-64 years. Enrolment: 24.
Status: Ended. Start date (EU): 2025-03-17. End date (EU): 2025-06-20. Decision date: 2025-02-06. Results received: No. Last updated: 2025-07-02.

Condition(s): Chronic obstructive pulmonary disease

Source: https://euclinicaltrials.eu/ctis-public/view/2024-516475-32-00